EU clinical trial 2023-504693-38-00: A study in healthy people to test whether iclepertin has an effect on cardiac safety
Protocol code: 1346-0051
Sponsor: Boehringer Ingelheim International GmbH (Industry). Phase: Human Pharmacology (Phase I)- Other. Countries: Germany (ended).
Therapeutic area(s): Diseases [C] - Nervous System Diseases [C10]
Gender: Female, Male. Age: 18-64 years. Enrolment: 56.
Status: Ended. Start date (EU): 2024-01-25. End date (EU): 2024-06-05. Decision date: 2023-10-24. Results received: No. Last updated: 2024-04-05.

Condition(s): Healthy

Source: https://euclinicaltrials.eu/ctis-public/view/2023-504693-38-00